EU clinical trial 2024-515051-38-00: A Two-Part Randomized, Phase 3 Study of Combinations of Cemiplimab (Anti- PD-1 Antibody) and Platinum-based Doublet Chemotherapy in First-line Treatment of Patients with Advanced or Metastatic Non-Small Cell Lung Cancer
Protocol code: R2810-ONC-16113
Sponsor: Regeneron Pharmaceuticals Inc. (Pharmaceutical company). Phase: Therapeutic confirmatory (Phase III). Countries: France (ended), Poland (ended), Ireland (ended), Greece (ended).
Therapeutic area(s): Diseases [C] - Neoplasms [C04]
Gender: Female, Male. Age: 18-64 years, 65+ years. Enrolment: 117.
Status: Ended. Start date (EU): 2018-07-20. End date (EU): 2025-02-27. End date: 2025-02-28. Decision date: 2024-09-26. Results received: Yes. Last updated: 2024-12-10.
Decision dates by country: FR: 2024-09-26, GR: 2024-12-10, IE: 2024-09-26, PL: 2024-09-30

Condition(s): Non-small Cell Lung Cancer
Product: Paclitaxel 6 mg/ml Concentrate for Solution for Infusion, Cisplatin 1 mg/ml Concentrate for Solution for Infusion, Armisarte 25 mg/ml concentrate for solution for infusion, YERVOY 5 mg/ml concentrate for solution for infusion, Carboplatin 10 mg/ml concentrate for solution for infusion, LIBTAYO 350 mg concentrate for solution for infusion.

Primary endpoint: Overall survival
Endpoint(s): Progression-free survival, Objective response rate, Duration of Response (DOR), Best overall response (BOR), Incidence of Treatment-emergent adverse events (TEAEs), Part 1 only: Incidence of Dose-limiting toxicities (DLTs), Incidence of serious adverse events (SAEs), Incidence of deaths, Incidence of laboratory abnormalities, Overall survival rate, Quality of life as measured by EORTC QLQ-C30, Quality of life as measured by EORTC QLQ-LC13

Source: https://euclinicaltrials.eu/ctis-public/view/2024-515051-38-00